EU clinical trial 2024-514094-22-00: Avoid Anticoagulation After IntraCerebral Haemorrhage
Protocol code: 2016_77
Sponsor: Centre Hospitalier Universitaire De Lille (Hospital/Clinic/Other health care facility). Phase: Therapeutic confirmatory (Phase III). Countries: France (ongoing, recruiting).
Therapeutic area(s): Diseases [C] - Nervous System Diseases [C10]
Gender: Female, Male. Age: 18-64 years, 65+ years. Enrolment: 300.
Status: Ongoing, recruiting. Start date (EU): 2019-01-18. Decision date: 2024-10-24. Results received: No. Last updated: 2026-03-30.

Condition(s): Intrecerebral Haemorrhage
Product: Eliquis 2.5 mg film-coated tablets

Primary endpoint: The primary endpoint is a composite criterion including all fatal or lifethreatening and major vascular events, i.e. cardiovascular/cerebrovascular ischaemic or haemorrhagic intracranial/extracranial events within 24 months after randomization
Endpoint(s): Each individual component of the composite outcome at 24 month after randomization (fatal or non-fatal major vascular events, i.e. cardiovascular/cerebrovascular ischaemic or haemorrhagic intracranial/extracranial events), Death of any cause at 24 months after randomization, Functional dependence scored on the modified Rankin Scale at 24 months after randomization in a shift analysis, Health-related quality of life measured by the EQ-5D (EuroQoL) at 24 months after randomization, Baseline small-vessel diseases biomarkers on brain MRI (brain microbleeds, leukoaraiosis, superficial siderosis, perivascular spaces, territorial infarcts, silent macrohaemorrhages, cortical atrophy), Complications of endovascular treatment (up to 30 days), Overall evaluation of the success of the procedure (at 30 days)

Source: https://euclinicaltrials.eu/ctis-public/view/2024-514094-22-00